EU clinical trial 2024-516124-34-00: Withdrawal of Tiratricol Treatment in Males with Monocarboxylate Transporter 8 Deficiency (MCT8 Deficiency): A Doubleblind, Randomized, Placebocontrolled Study (MCT8-2021-3 (ReTRIACt))
Protocol code: MCT8-2021-3
Sponsor: Rare Thyroid Therapeutics International AB (Pharmaceutical company). Phase: Therapeutic confirmatory (Phase III). Countries: Netherlands (ended).
Therapeutic area(s): Diseases [C] - Hormonal diseases [C19]
Gender: Male. Age: 0-17 years, 18-64 years. Enrolment: 5.
Status: Ended. Start date (EU): 2023-07-21. End date (EU): 2025-09-03. End date: 2025-09-04. Decision date: 2024-09-23. Results received: Yes. Last updated: 2025-12-12.

Condition(s): Monocarboxylate Transporter 8 (MCT8) deficiency
Product: Tiratricol, Matching placebo (for participants allocated to the placebo group in the Randomized Treatment Period)

Primary endpoint: Primary endpoint 1: Rate of change from baseline in serum total T3 during the 30-day double-blind Randomized Treatment Period. Primary endpoint 2: Proportion of participants who meet the rescue criterion (serum total T3 > ULN) during the 30-day double-blind Randomized Treatment Period.
Endpoint(s): Change in serum thyroid hormone variables (T3, T4, TSH, fT3 and fT4) from baseline to the end of Randomized Treatment Period, Change in serum thyroid hormone variables (T3, T4, TSH, fT3, and fT4) from screening to End of Study, Change in serum thyroid hormone variables (T3, T4, TSH, fT3, and fT4) from initiation of tiratricol administration at enrolment to the last measurement prior to randomization, Change in clinical endpoints: Heart rate (HR), systolic blood pressure (SBP) and rate pressure product (RPP) from baseline to the end of Randomized Treatment Period, Change in clinical endpoints: HR, SBP, RPP and body weight from screening to End of Study, Change in clinical endpoints: HR, SBP, RPP from initiation of tiratricol administration at screening to the last measurement prior to randomization

Source: https://euclinicaltrials.eu/ctis-public/view/2024-516124-34-00